EU clinical trial 2024-510991-19-00: A multicenter, open-label, randomized, phase 2 study of venetoclax and azacitidine plus cusatuzumab versus venetoclax and azacitidine alone in newly diagnosed AML patients who are not candidates for intensive therapy
Protocol code: OV-AML-1231
Sponsor: Oncoverity Inc. (Pharmaceutical company). Phase: Therapeutic exploratory (Phase II). Countries: Germany (ongoing, recruitment ended), Spain (ongoing, recruitment ended).
Therapeutic area(s): Diseases [C] - Neoplasms [C04]
Gender: Female, Male. Age: 18-64 years, 65+ years. Enrolment: 29.
Status: Ongoing, recruitment ended. Start date (EU): 2024-08-14. Decision date: 2024-07-19. Results received: No. Last updated: 2026-07-09.
Decision dates by country: ES: 2025-08-01, DE: 2024-07-19

Condition(s): Acute myeloid leukemia
Product: Venclyxto 50 mg film-coated tablets, Cusatuzumab, Azacitidina Zentiva 25 mg/ml polvere per sospensione iniettabile, Venclyxto 100 mg film-coated tablets, Venclyxto 10 mg film-coated tablets

Primary endpoint: Overall survival (OS)
Endpoint(s): Complete remission (CR) rate defined as rate of complete remission per European Leukemia Network (ELN) 2022, Event-free survival (EFS) per ELN 2022, Composite CR (CRc) rate = the sum of rates for CR+CRh+CRi (CRh and CRi is defined as CR with partial hematologic recovery and incomplete hematologic recovery respectively) per ELN 2022, Rates of CRh, CRi, and MLFS, Duration of complete remission defined as the time from first CR to hematological relapse or death from any cause, Time to first complete remission defined as time from randomization to first occurrence of CR, Rate of measurable residual disease (MRD) negativity in participants achieving CR, CRh or CRi per ELN 2022 guidelines for MRD testing, Proportion of participants proceeding to hematopoietic stem cell transplantation (HSCT), OS in participants undergoing HSCT, Adverse events (AEs) per NCI CTCAE criteria, Serious AEs (SAEs) and AEs leading to study drug discontinuation, Incidence of dose modifications (interruptions/delays) due to AEs, Clinical laboratory tests, ECGs, physical examination findings, and vital signs, Serum concentration-time data and pharmacokinetic parameters as feasible for cusatuzumab, Incidence of anti-cusatuzumab antibodies, Incidence of neutralizing antibodies (NAb), OS and CR as well as other endpoints, Rate of conversion from MRD negativity to MRD positivity in participants achieving CR, CRh or CRi

Source: https://euclinicaltrials.eu/ctis-public/view/2024-510991-19-00